EU clinical trial 2025-524241-27-00: A Randomized, Double-Blind, Multicenter, Placebo-Controlled Phase 3 Study of Orelabrutinib in Combination with Rituximab and Bendamustine (BR) vs. BR in Subjects with Treatment-Naїve Mantle Cell Lymphoma
Protocol code: ICP-CL-00128
Sponsor: Innocare Pharma Inc. (Pharmaceutical company). Phase: Therapeutic confirmatory (Phase III). Countries: Poland (authorised, recruitment pending), France (authorised, recruitment pending), Czechia (authorised, recruitment pending), Spain (authorised, recruitment pending), Romania (authorised, recruitment pending).
Therapeutic area(s): Diseases [C] - Neoplasms [C04]
Gender: Female, Male. Age: 18-64 years, 65+ years. Enrolment: 102.
Status: Authorised, recruitment pending. Decision date: 2026-06-01. Results received: No. Last updated: 2026-07-29.
Decision dates by country: CZ: 2026-06-01, RO: 2026-06-08, ES: 2026-06-04, FR: 2026-06-01, PL: 2026-06-05

Condition(s): Treatment-naїve mantle cell lymphoma (MCL)
Product: Bendamustine Glenmark, 2,5 mg/ml, proszek do sporządzania koncentratu roztworu do infuzji, Tablet matching the appearance of orelabrutinib (used only at randomisation stage, not at safety and tolerability stage), Truxima 100 mg concentrate for solution for infusion, Orelabrutinib

Primary endpoint: Randomization Stage: Progression-free survival (PFS) assessed by Independent Review Committee (IRC) according to the 2014 International Working Group Criteria for Non-Hodgkin Lymphoma (iwNHL)
Endpoint(s): Randomization Stage: Overall Survival (OS), Randomization Stage: Efficacy Endpoints o PFS assessed by Investigator according to iwNHL o ORR, CRR. DOR and TTR assessed by IRC and Investigator according to iwNHL Time to next treatment (TTNT), Randomization Stage: Safety Endpoints AEs assessed by CTCAE v5.0 criteria, VS, PE, ECG, ECOG performance status and laboratory findings, Randomization Stage: o PK Endpoint o Plasma concentrations of orelabrutinib, Randomization Stage: Assessment of Patient-Reported Outcomes o Quality of life assessment: Time to worsening, health score and changes from baseline in FACT-Lym and EQ-5D-5L

Source: https://euclinicaltrials.eu/ctis-public/view/2025-524241-27-00